EU clinical trial 2023-510137-29-01: A Phase 2, Randomized, Double-blind, Placebo-controlled Study to Evaluate the Efficacy, Safety, Tolerability, and Pharmacodynamics of Intrathecally Administered ALN-APP in Patients with Cerebral Amyloid Angiopathy (CAA)
Protocol code: ALN-APP-002
Sponsor: Alnylam Pharmaceuticals Inc. (Pharmaceutical company). Phase: Therapeutic exploratory (Phase II). Countries: Netherlands (ongoing, recruitment ended).
Therapeutic area(s): Diseases [C] - Nervous System Diseases [C10]
Gender: Female, Male. Age: 18-64 years, 65+ years. Enrolment: 50.
Status: Ongoing, recruitment ended. Start date (EU): 2025-04-09. Decision date: 2025-03-24. Results received: No. Last updated: 2026-02-18.

Condition(s): Cerebral Amyloid Angiopathy (CAA) is a neurological condition in which amyloid proteins build up in the walls of blood vessels in the brain, causing problems such as bleeding into the brain
Product: Mivelsiran, Placebo

Primary endpoint: Annualized rate of new lobar Cerebral Microbleeds as detected by MRI in patients with Cerebral Amyloid Angiopathy (sCAA)
Endpoint(s): Global rank of patients based on clinical or MRI imaging outcomes by severity, count, presence of symptoms, and timing of: - New ICH - New cSS or cSAH - New lobar CMBs, Change from baseline over time in BOLD slope (amplitude over time-to-peak), amplitude, and time-to-peak detected, in a subset of enrolled patients, by visual-evoked fMRI, • Total number of new lobar CMBs over time detected by MRI • New ICH over time as detected by MRI or clinical diagnosis • Time to first ICH recurrence • New/extended cSS or new cSAH over time as detected by MRI or clinical diagnosis • Proportion of patients with hemorrhagic disease progression over time detected by MRI or clinical diagnosis where appropriate. • Total number of new symptomatic hemorrhages over time • Change from baseline over time in WMH volume, Change from baseline over time in total CAA SVD score as detected by MRI based on: - Lobar CMBs - CSO PVS - WMH - cSS, Change from baseline over time in sAPPα and in sAPPβ concentration in CSF

Source: https://euclinicaltrials.eu/ctis-public/view/2023-510137-29-01